EU clinical trial 2023-509722-22-00: Nebulized Amikacine for Ventilator associated gram negative Pneumonia in ECMO veno-arterial patients: A randomized Pilot Study (NAVAP-ECMO)
Protocol code: APHP221166
Sponsor: Assistance Publique Hopitaux De Paris (Hospital/Clinic/Other health care facility). Phase: Therapeutic exploratory (Phase II). Countries: France (authorised, recruitment pending).
Therapeutic area(s): Diseases [C] - Respiratory Tract Diseases [C08]; Diseases [C] - Bacterial Infections and Mycoses [C01]
Gender: Female, Male. Age: 18-64 years, 65+ years. Enrolment: 26.
Status: Authorised, recruitment pending. Decision date: 2024-06-27. Results received: No. Last updated: 2026-05-18.

Condition(s): gram-negative bacillus pneumonia acquired during mechanical ventilation in patients receiving Extracorporeal Membrane veno-arterial oxygenation
Product: CEFEPIME, AMIKACIN, PIPERACILLIN AND BETA-LACTAMASE INHIBITOR

Primary endpoint: Bacterial eradication rate, defined as absence of germs on direct examination and negative culture of a tracheal aspirate taken on day 5 (D5) after randomisation and at least 12 hours after the last administration of inhaled amikacin
Endpoint(s): Clinical cure rate, defined as the disappearance of clinical signs suggestive of pneumonia, biological inflammatory syndrome, and correction of haematosis disorders, at D5, Pneumonia persistence rate defined as the presence of the pathogen identified at a significant level on culture of tracheal aspirate at D5, Difference between CPIS score at D5 and CPIS score at randomization, Difference between ultrasound lung ventilation score at D5 and lung ventilation score at randomization, Quantifying and analysing adverse events, Pharmacokinetic analysis of plasma concentrations of piperacillin-tazobactam, Measurement of the ratio of penetration into alveolar fluid (AUC alveolar fluid/AUC plasma) of piperacillin-tazobactam in patients undergoing VA-ECMO after 2 days of intravenous antibiotic therapy

Source: https://euclinicaltrials.eu/ctis-public/view/2023-509722-22-00